EU clinical trial 2026-526465-18-00: Evaluating the effect of inhaled levodopa (Inbrija®) for early morning off in Parkinson’s disease
Sponsor: Region Hovedstaden (Hospital/Clinic/Other health care facility). Phase: Therapeutic confirmatory (Phase III). Countries: Denmark (authorised, recruitment pending).
Therapeutic area(s): Diseases [C] - Nervous System Diseases [C10]
Gender: Female, Male. Age: 18-64 years, 65+ years. Enrolment: 22.
Status: Authorised, recruitment pending. Decision date: 2026-06-25. Results received: No. Last updated: 2026-06-25.

Condition(s): parkinson's disease
Product: Inbrija 33 mg inhalation powder, hard capsules, Madopar Quick "125"

Primary endpoint: Time in minutes from completion of the assigned morning study dose (T0) to the first PKG-defined ON state per valid morning, evaluated within a 0–120-minute post-dose window and truncated at 120 minutes.
Endpoint(s): Patient-reported time-to-ON following the morning dose, Overall preferred morning treatment, Experience with use of the treatment, Early-morning motor function, ease of initiating morning activities, perceived independence, and perceived confidence/security, Unified Parkinson’s Disease Rating Scale, Part II (MDS-UPDRS-II), Parkinson’s Disease Questionnaire (PDQ-8), Non-Motor Symptoms Scale (MDS-NMS-Q), Proportion of PKG epochs below a fixed bradykinesia threshold (BKS < 25) within predefined post-dose windows (0–10, 0–20, 0–30, and 0–60 minutes after morning dosing), Proportion of PKG epochs below the individualized threshold (BKS < θ) within the same post-dose windows, Early-morning physical activity and inactivity, quantified using PKG-derived activity metrics (including immobility time), Pre-dose baseline motor severity during run-in, defined as the mean PKG BKS in the 10 minutes preceding the participant’s first levodopa/DDCI dose of the day., Time spent in OFF, ON, and dyskinetic states over the day, expressed as the proportion of valid daytime epochs in each state. States will be defined using fixed PKG thresholds: OFF: BKS ≥ 25 ON: BKS < 25 and DKS ≤ 9 Dyskinesia: DKS > 9, Sleep-related PKG metrics derived from nocturnal recordings (e.g., total sleep duration, sleep efficiency, nocturnal immobility, and sleep fragmentation), summarised per night and averaged within each intervention period.

Source: https://euclinicaltrials.eu/ctis-public/view/2026-526465-18-00